EU clinical trial 2024-516002-33-01: Control Crohn Safe with episodic adalimumab monotherapy as first line treatment study
Sponsor: Universiteit Maastricht (Educational Institution). Phase: Therapeutic use (Phase IV). Countries: Netherlands (ongoing, recruitment ended).
Therapeutic area(s): Diseases [C] - Digestive System Diseases [C06]; Analytical, Diagnostic and Therapeutic Techniques and Equipment [E] - Therapeutics [E02]
Gender: Female, Male. Age: 18-64 years, 65+ years. Enrolment: 158.
Status: Ongoing, recruitment ended. Start date (EU): 2019-12-23. Decision date: 2024-12-17. Results received: No. Last updated: 2024-12-17.

Condition(s): Crohn's disease
Product: Hyrimoz 40 mg solution for injection in pre-filled syringe

Primary endpoint: The primary endpoint is the difference in number of yearly-quarters of corticosteroid free clinical and biochemical remission at week 96. Safety outcomes are disease progression at week 96, drug related adverse events and disease related serious adverse events (hospitalisations, surgery).
Endpoint(s): The secondary outcomes are total health care costs, cumulative corticosteroid dose, proportion of patients with endoscopic remission at week 24, drug-related side effects and patient reported outcome measures on quality of life, (work) disability and treatment-tolerability.

Source: https://euclinicaltrials.eu/ctis-public/view/2024-516002-33-01